EU clinical trial 2022-502872-22-00: B7981078: A PHASE 1, RANDOMIZED, OPEN-LABEL, CROSSOVER STUDY TO ESTIMATE THE RELATIVE BIOAVAILABILITY OF PEDIATRIC RITLECITINIB (PF-06651600) SPRINKLED IN APPLESAUCE, YOGHURT AND STRAWBERRY JAM RELATIVE TO INTACT BLEND-IN CAPSULE OF RITLECITINIB AND THE EFFECT OF FOOD ON THE BIOAVAILABILITY OF THE CAPSULE DOSAGE FORMULATION OF RITLECITNIB IN HEALTHY ADULT PARTICIPANTS
Protocol code: B7981078
Sponsor: Pfizer Inc. (Pharmaceutical company). Phase: Human Pharmacology (Phase I)- Other. Countries: Belgium (ended).
Therapeutic area(s): Diseases [C] - Skin and Connective Tissue Diseases [C17]; Diseases [C] - Digestive System Diseases [C06]; Diseases [C] - Musculoskeletal Diseases [C05]
Gender: Female, Male. Age: 18-64 years, 65+ years. Enrolment: 12.
Status: Ended. Start date (EU): 2023-04-28. End date (EU): 2023-07-24. End date: 2023-07-25. Decision date: 2023-03-20. Results received: Yes. Last updated: 2023-03-20.

Condition(s): Alopecia Areata, Rheumatoid Arthritis, Vitiligo, Ulcerative Colitis and Crohn's Disease
Product: Ritlecitinib

Primary endpoint: Plasma AUCinf and Cmax of ritlecitinib
Endpoint(s): AE monitoring

Source: https://euclinicaltrials.eu/ctis-public/view/2022-502872-22-00